EU clinical trial 2025-522556-10-01: Evaluation of Tildrakizumab in the Treatment of Ocular Sequelae in Lyell syndrome
Sponsor: TOXILYON (Health care). Phase: Therapeutic exploratory (Phase II). Countries: France (authorised, recruitment pending).
Therapeutic area(s): Diseases [C] - Eye Diseases [C11]; Diseases [C] - Immune System Diseases [C20]
Gender: Female, Male. Age: 18-64 years, 65+ years. Enrolment: 10.
Status: Authorised, recruitment pending. Decision date: 2026-01-23. Results received: No. Last updated: 2026-01-23.

Condition(s): Ocular Sequelae in Lyell syndrome
Product: Ilumetri 200 mg solution for injection in pre-filled syringe

Primary endpoint: The primary efficacy endpoint of this study is the change in tear film break-up time (TBUT), measured in seconds, between baseline (Day 0) and post-treatment follow-up visits, Secondary efficacy endpoints will consist of patient-reported outcome measures designed to capture the subjective impact of treatment on ocular symptoms and vision-related quality of life.
Endpoint(s): Clinical Safety Monitoring, Patient-Reported Tolerability via DL-QI

Source: https://euclinicaltrials.eu/ctis-public/view/2025-522556-10-01